EU clinical trial 2023-503282-27-00: A Phase 2/3 Single-Arm, Open-label Study to Evaluate the Safety, Pharmacokinetics and Efficacy of Obeldesivir in Pediatric Participants With COVID-19
Protocol code: GS-US-611-6464
Sponsor: Gilead Sciences Inc. (Pharmaceutical company). Phase: Phase II and Phase III (Integrated). Countries: Poland (ended), Spain (ended), Italy (ended), Hungary (ended), Bulgaria (ended).
Therapeutic area(s): Diseases [C] - Virus Diseases [C02]
Gender: Female, Male. Age: 0-17 years. Enrolment: 22.
Status: Ended. End date (EU): 2024-03-05. End date: 2024-03-06. Decision date: 2023-12-13. Results received: Yes. Last updated: 2024-02-01.
Decision dates by country: ES: 2023-12-18, IT: 2023-12-13, PL: 2023-12-14, HU: 2023-12-14, BG: 2023-12-18

Condition(s): COVID-19
Product: GS-5245 tablets 175 mg, GS-5245 tablets 350 mg

Primary endpoint: PK parameters (AUC0-12, Cmax, and Ctrough) for ODV metabolite, GS-441524, Incidence of treatment-emergent AEs by Day 35, Incidence of treatment-emergent laboratory abnormalities by Day 35
Endpoint(s): Time to sustained alleviation of targeted COVID-19 symptoms by Day 35, Change from baseline in SARS-CoV-2 nasal swab viral load at Day 5, Proportion of participants who require supplemental oxygen support (low flow oxygen, high flow oxygen, noninvasive ventilation, mechanical ventilation, or extracorporeal membrane oxygenation) by Day 35, Assessment of palatability and acceptability scores of each formulation at Day 5, Proportion of participants with concomitant use of medications other than remdesivir and ODV for treatment of COVID-19 by Day 35, Proportion of participants with COVID-19-related hospitalization or all-cause death by Day 35

Source: https://euclinicaltrials.eu/ctis-public/view/2023-503282-27-00